EU clinical trial 2022-500838-28-00: A Phase I/II Study of Neoadjuvant, Intra-arterial Administration of [177Lu]Lu-PSMA-617 in Subjects with High-risk, Localised or Locally Advanced Prostate Cancer who are Candidates for Radical Prostatectomy (LUPUS)
Protocol code: LUPUS
Sponsor: Universitaetsklinikum Essen AöR (Hospital/Clinic/Other health care facility). Phase: Phase I and Phase II (Integrated)- Other. Countries: Germany (ongoing, recruiting).
Therapeutic area(s): Diseases [C] - Male Urogenital Diseases [C12]
Gender: Male. Age: 18-64 years, 65+ years. Enrolment: 22.
Status: Ongoing, recruiting. Start date (EU): 2024-09-10. Decision date: 2023-11-27. Results received: No. Last updated: 2026-07-01.

Condition(s): high-risk localized or locally advanced prostate cancer
Product: Pluvicto 1 000 MBq/mL solution for injection/infusion

Primary endpoint: Adverse Events related to intra-arterial [177Lu]Lu-PSMA-617 therapy, Days of delay of scheduled surgery due to AEs related to intra-arterial [177Lu]Lu-PSMA-617 therapy
Endpoint(s): PSA-response, Pathological response as measured by pathological complete response (pCR) and minimal residual disease (MRD), defined as a tumour burden of 5 mm or less in greatest dimensions.

Source: https://euclinicaltrials.eu/ctis-public/view/2022-500838-28-00